EU clinical trial 2024-516020-33-00: A Randomized, Double-Blind, Placebo-Controlled, Phase 2b Study to Assess the Efficacy, Safety, and Tolerability of IMVT-1402 as Treatment for Adult Patients With Graves' Disease
Protocol code: IMVT-1402-2502
Sponsor: Immunovant Sciences GmbH (Pharmaceutical company). Phase: Therapeutic exploratory (Phase II). Countries: Spain (ongoing, recruiting), Hungary (ongoing, recruiting), Germany (ongoing, recruiting), Italy (ongoing, recruiting), Belgium (ongoing, recruiting), Poland (ongoing, recruiting).
Therapeutic area(s): Diseases [C] - Immune System Diseases [C20]
Gender: Female, Male. Age: 18-64 years, 65+ years. Enrolment: 158.
Status: Ongoing, recruiting. Start date (EU): 2025-06-26. Decision date: 2025-06-05. Results received: No. Last updated: 2026-04-17.
Decision dates by country: BE: 2025-06-06, DE: 2025-06-06, HU: 2025-06-06, IT: 2025-06-06, ES: 2025-06-05, PL: 2025-06-10

Condition(s): Grave’s Disease
Product: Placebo is identical to IMP but with no active substance., IMVT-1402

Primary endpoint: Proportion of participants who are euthyroid and off ATD at Week 26
Endpoint(s): Proportion of participants who are euthyroid and off ATD at Week 52, Proportion of participants who are euthyroid, off ATD, and seronegative for TRAb at Week 52, Proportion of participants who are euthyroid and off ATD at Week 52 and remain euthyroid, off IMVT-1402, and off ATD for 6 months from Week 52 to Week 78, Proportion of participants who are euthyroid and off ATD at Week 52 and remain euthyroid, off IMVT-1402, and off ATD for 12 months from Week 52 to Week 104, Proportion of participants who have a TRAb value at Week 25 and are euthyroid and off ATD at Week 26 and remain euthyroid, off IMVT-1402, and off ATD for 6 months from Week 26 to Week 52, Proportion of participants who have a TRAb value at Week 25 and are euthyroid and off ATD at Week 26 and remain euthyroid, off IMVT-1402, and off ATD for 12 months from Week 26 to Week 78, Proportion of participants who have T3 (Total T3 or FT3) and FT4 ≤ ULN at Week 2 in participants who have T3 (Total T3 or FT3) and/or FT4 > ULN at baseline, Proportion of participants who have T3 (Total T3 or FT3) and FT4 ≤ ULN at Week 4 in participants who have T3 (Total T3 or FT3) and/or FT4 > ULN at baseline, Proportion of participants who are euthyroid, off ATD, and seronegative for TRAb at Week 26, Proportion of participants who have T3 (Total T3 or FT3) and FT4 ≤ ULN and are off ATD at Week 26, Proportion of participants who have T3 (Total T3 or FT3) and FT4 ≤ ULN and are off ATD at Week 52

Source: https://euclinicaltrials.eu/ctis-public/view/2024-516020-33-00